EU clinical trial 2023-503640-14-00: Phase 3 Randomized, Controlled Study of Blinatumomab Alternating With Low-intensity Chemotherapy Versus Standard of Care for Older Adults With Newly Diagnosed Philadelphia-negative B-cell Precursor Acute Lymphoblastic Leukemia With Safety Run-in (Golden Gate Study)
Protocol code: 20190360
Sponsor: Amgen Inc. (Pharmaceutical company). Phase: Therapeutic confirmatory (Phase III). Countries: Belgium (ongoing, recruitment ended), Denmark (ongoing, recruitment ended), Netherlands (ongoing, recruitment ended), Sweden (ongoing, recruitment ended), Spain (ongoing, recruitment ended), Romania (ongoing, recruitment ended), Austria (ended), France (ongoing, recruitment ended), Portugal (ongoing, recruitment ended), Finland (ongoing, recruitment ended), Hungary (ongoing, recruitment ended), Italy (ongoing, recruitment ended), Greece (ongoing, recruitment ended), Bulgaria (ongoing, recruitment ended), Czechia (ongoing, recruitment ended), Estonia (ended), Slovakia (authorised, recruiting).
Therapeutic area(s): Diseases [C] - Neoplasms [C04]
Gender: Female, Male. Age: 18-64 years, 65+ years. Enrolment: 173.
Start date (EU): 2022-02-17. Decision date: 2024-04-18. Results received: No. Last updated: 2026-03-09.
Decision dates by country: AT: 2024-04-23, RO: 2024-04-23, BE: 2024-04-18, NL: 2024-04-19, ES: 2024-04-19, EE: 2025-06-02, PT: 2024-04-18, GR: 2024-06-17, CZ: 2025-05-29, FI: 2024-04-19, FR: 2024-04-25, HU: 2024-04-19, DK: 2024-04-18, IT: 2024-04-22, SK: 2025-05-23, SE: 2024-04-19, BG: 2024-04-24

Condition(s): Newly diagnosed Philadelphia-negative B-cell precursor Acute Lymphoblastic Leukemia in older adults
Product: DEXAMETHASONE, RITUXIMAB, BLINATUMOMAB, MERCAPTOPURINE, RITUXIMAB, BLINATUMOMAB, CYCLOPHOSPHAMIDE, PREDNISONE, CYTARABINE, IDARUBICIN, PREDNISOLONE, METHOTREXATE SODIUM, DEXAMETHASONE, DEXAMETHASONE, CYCLOPHOSPHAMIDE, PEGASPARGASE, DOXORUBICIN, CYTARABINE, DEXAMETHASONE, MERCAPTOPURINE, VINCRISTINE SULFATE, METHOTREXATE SODIUM, METHOTREXATE SODIUM, VINCRISTINE SULFATE, ASPARAGINASE, CRISANTASPASE, METHOTREXATE SODIUM

Primary endpoint: SRI: Treatment-emergent adverse events, treatment-related adverse events, and adverse events of interest, Ph3: EFS: time from randomization until treatment failure, relapse, or death from any cause, whichever is earlier. Subjects without an event will be censored at their last evaluable disease assessment date., Ph3: OS: time from randomization until death due to any cause. Subjects alive will be censored at the date last known to be alive.
Endpoint(s): SRI: Complete remission (CR) by the end of the initial disease assessment period, SRI: Minimal residual disease (MRD) response < 10-4 by the end of the initial disease assessment period, SRI: Relapse-free survival (RFS): in subjects who achieve CR, the time from first achievement of this response until date of the first relapse including hematologic relapse, extramedullary relapse, or death due to any cause, whichever occurs first. Subjects without an event will be censored at their last evaluable disease assessment date., SRI: MRD RFS in subjects who achieve CR with MRD response, the time from first achievement of this response until date of the first relapse including molecular relapse, hematologic relapse, and/or extramedullary relapse, or death due to any cause, whichever occurs first. Molecular relapse will be defined 2 ways: MRD ≥ 10-3 and MRD 10-4. Subjects without an event will be censored at their last evaluable disease assessment date., SRI: PK parameters for blinatumomab including, but not limited to, steady state concentration (Css) and clearance (CL), Ph3: Change from baseline to end of the initial disease assessment period in fatigue score measured by Patient-Reported Outcomes Measurement Information System (PROMIS) Fatigue – Short Form 7a, Ph3: Change from baseline to end of the initial disease assessment period in pain score measured by Brief Pain Inventory – Short Form (BPI-SF); Item 3: pain at its worst in the last 24 hours, Ph3: Change from baseline to end of the initial disease assessment period in global health status measured by the QLQ-C30 global health status quality of life scale, Ph3: Change from baseline to end of the initial disease assessment period in physical function measured by the QLQ-C30 functional scale, Ph3: Change from baseline to end of the initial disease assessment period in nausea/vomiting measured by the QLQ-C30 symptom scale, Ph3: CR by the end of the initial disease assessment period, Ph3: MRD response < 10-4 by the end of the initial disease assessment period, Ph3: RFS: in subjects who achieve CR, the time from first achievement of this response until date of the first relapse including hematologic relapse, extramedullary relapse, or death due to any cause, whichever occurs first. Subjects without an event will be censored at their last evaluable disease assessment date., Ph3: MRD RFS in subjects who achieve CR with MRD response, the time from first achievement of this response until date of the first relapse including molecular relapse, hematologic relapse, and/or extramedullary relapse, or death due to any cause, whichever occurs first. Molecular relapse will be defined 2 ways: MRD ≥ 10-3 and MRD 10-4. Subjects without an event will be censored at their last evaluable disease assessment date., Ph3: MRD level over time, Ph3: treatment-emergent adverse events, treatment related adverse events, and adverse events of interest, Ph3: CD19 positive relapse and CD19 negative relapse identified by flow cytometry or immunocytochemistry for bone marrow (mandatory), Ph3: CD19 positive relapse and CD19 negative relapse identified by flow cytometry or immunohistochemistry for cerebrospinal fluid (mandatory), Ph3: CD19 positive relapse and CD19 negative relapse for extramedullary sites other than cerebrospinal fluid (optional - if data is available), Ph3: Lineage switch to acute myeloid leukemia (AML), Ph3: Localization of relapse by clinical assessment, Ph3: Mortality in CR, Ph3: Autologous and allogeneic HSCT in continuous first CR*, Ph3: Mortality in CR after autologous and allogeneic HSCT*, Ph3: Relapse after autologous and allogeneic HSCT, Ph3: Time to deterioration and time to improvements for fatigue score measured by PROMIS Fatigue – Short Form 7a, Ph3: Time to deterioration and time to improvements for pain score measured by BPI-SF; Item 3: pain at its worst in the last 24 hours, Ph3: Change from baseline in all other subscales of QLQ-C30 (role, cognitive, emotional, and social scales; pain and fatigue scales; single items: dyspnea, loss of appetite, insomnia, constipation, diarrhea, and perceived financial impact), Ph3: Time to deterioration and time to improvements for global health status, physical function, and nausea/vomiting scales., Ph3: Css and CL

Source: https://euclinicaltrials.eu/ctis-public/view/2023-503640-14-00